EU clinical trial 2025-521772-57-00: A Phase 3b open-label, randomised study of IPX203 in subjects with advanced Parkinson’s disease and motor fluctuations - ADIP study
Protocol code: ZB203L01
Sponsor: Zambon Biotech S.A. (Pharmaceutical company). Phase: Therapeutic confirmatory (Phase III). Countries: Spain (ongoing, recruitment ended), Italy (ongoing, recruitment ended), Poland (ongoing, recruitment ended).
Therapeutic area(s): Diseases [C] - Nervous System Diseases [C10]
Gender: Female, Male. Age: 18-64 years, 65+ years. Enrolment: 91.
Status: Ongoing, recruitment ended. Start date (EU): 2025-11-06. Decision date: 2025-10-06. Results received: No. Last updated: 2026-06-16.
Decision dates by country: PL: 2025-10-10, ES: 2025-10-09, IT: 2025-10-06

Condition(s): Motor fluctuations in advanced Parkinson’s disease
Product: LEVODOPA AND DECARBOXYLASE INHIBITOR, H006629, H006629, H006629, H006629

Primary endpoint: 1. The primary endpoint is the change in good ON time at Week 12 compared to baseline for IPX203 versus IR LD/AAADI (>1 hour; ≤1 hour)
Endpoint(s): 1. Change from baseline in OFF time at Week 12 (key secondary), 2. Change from baseline in good ON time, ON time, change from baseline in ON time with dyskinesia, change from baseline in ON time with troublesome dyskinesia, change from baseline in ON time with non-troublesome dyskinesia, and change from baseline in ON time without dyskinesia (all derived from the Parkinson’s disease diary) up to Visit 5, 3. Change from baseline scores for the clinical outcome assessments listed in the protocol.

Source: https://euclinicaltrials.eu/ctis-public/view/2025-521772-57-00